EU clinical trial 2024-515386-34-00: A Phase 2, Open-label Study to Evaluate the Safety, Tolerability, and Efficacy of Intravenous NVG-2089 in Participants with Chronic Inflammatory Demyelinating Polyneuropathy (CIDP)
Protocol code: NVG-2089-201
Sponsor: Nuvig Therapeutics Inc. (Pharmaceutical company). Phase: Therapeutic exploratory (Phase II). Countries: Spain (ended), France (ended), Poland (ended), Bulgaria (ended), Belgium (ended), Italy (ended).
Therapeutic area(s): Diseases [C] - Nervous System Diseases [C10]; Diseases [C] - Immune System Diseases [C20]
Gender: Female, Male. Age: 18-64 years, 65+ years. Enrolment: 99.
Status: Ended. Start date (EU): 2025-05-29. End date (EU): 2026-05-04. End date: 2026-07-10. Decision date: 2025-04-18. Results received: No. Last updated: 2026-03-05.
Decision dates by country: ES: 2025-04-21, BE: 2025-04-18, FR: 2025-07-03, PL: 2025-04-27, IT: 2025-04-23, BG: 2025-04-23

Condition(s): Chronic Inflammatory Demyelinating Polyneuropathy (CIDP)
Product: NVG-2089

Primary endpoint: Incidence, nature, and severity of treatment-emergent adverse events (TEAEs), and serious adverse events (SAEs), Clinically significant findings of laboratory, vital signs, electrocardiogram, and physical examinations
Endpoint(s): Treatment-naïve Participants (endpoints evaluated at Week 14 and Week 26): Percentage of participants with ECI. ECI is defined as improvement of 1 point on the adjusted Inflammatory Neuropathy Cause and Treatment (adjusted INCAT) score, or 4 points on I-RODS or 8 kPa on mean grip strength (dominant hand)., Treatment-experienced Participants (endpoints evaluated at W14 and 26): Percentage of participants who meet any of the following conditions: - Achieving ECI - No worsening in adjusted INCAT after W4 and through endpoint assessment period (W14 and 26) - Worsening in adjusted INCAT between D1 and W4 (and have not received rescue medication) followed by an improvement to baseline by W4 and maintained through endpoint assessment period (W14 and 26), Treatment-experienced Participants: Percentage of participants who meet any of the following conditions: - No worsening in adjusted INCAT after Weeks 4 and through endpoint assessment period (Weeks 14 and 26) - Worsening in adjusted INCAT between Day 1 and Week 4 (and have not received rescue medication) followed by an improvement to baseline by Week 4 and maintained through endpoint assessment period (Weeks 14 and 26), Treatment-experienced Participants: Percentage of participants with ECI Note, endpoints for treatment-naïve participants evaluate improvement, whereas endpoints for treatment-experienced participants evaluate no worsening as well as improvement., Change from baseline over time in: - Adjusted INCAT score - Medical Research Council (MRC) sum score - I-RODS disability scores - Mean grip strength, The PK parameters of NVG-2089 concentrations in plasma, Incidence and characteristics of ADA after dosing, PK concentrations and safety profile in participants with ADA

Source: https://euclinicaltrials.eu/ctis-public/view/2024-515386-34-00